EU clinical trial 2024-512283-65-00: Exploring the effect of a novel therapy on chronic intrathecal inflammation in patients with active progressive multiple sclerosis
Protocol code: GR-2021-12373041
Sponsor: Azienda Ospedaliera Universitaria Integrata Verona (Hospital/Clinic/Other health care facility). Phase: Therapeutic use (Phase IV). Countries: Italy (ongoing, recruiting).
Therapeutic area(s): Diseases [C] - Nervous System Diseases [C10]
Gender: Female, Male. Age: 18-64 years. Enrolment: 40.
Status: Ongoing, recruiting. Start date (EU): 2023-05-29. Decision date: 2024-08-06. Results received: No. Last updated: 2024-08-06.

Condition(s): patients with secondary progressive MS
Product: Mayzent 0.25 mg film-coated tablets, Mayzent 2 mg film-coated tablets

Primary endpoint: To characterize the effect of the drug on cerebrospinal fluid markers of chronic intrathecal inflammation. According to literature, to our previous studies and preliminary data, that pointed to a key role of CXCL13 in mediating B-cell accumulation and its association with disease severity and progression, the sample size has been calculated taking in account as primary endpoint to measure changes in the CSF levels of CXCL13.
Endpoint(s): the characterization of intrathecal (and paired blood) adaptive and immune cell subsets through a high-dimensional flow cytometry performed at T0 and after two years of treatment (T24), Evaluation of paired blood and CSF markers of inflammation and neurodegeneration at T0 and T24, Assessment of CSF oligoclonal bands status and number at T0 and after two years of treatment (T24), Assessment of the main pro-inflammatory (e.g., prostaglandins and leukotriens) and pro-resolving (e.g., resolvins, protectins, maresins and lipoxins) lipids at T0 and T24, evaluation of cortical lesions (CLs) number and volume and their changes, evaluation of chronic active lesions number and evolution (such analysis will be performed by identifying rim-positive lesions on SWI), the rate of global and regional cortical thickness change using 3D T1 FFE sequences, longitudinal change of MTSat/MWF multiparametric combination will be computed in WM lesions and normal appearing white matter, longitudinal changes in the cross sectional area of the spinal cord., To evaluate the EDSS change before, during, and after the treatment, To evaluate changes in cognitive functioning from T0 to T24, Treatment emergent adverse effect (TEAE) and serious adverse event (SAE) at each follow-up visit

Source: https://euclinicaltrials.eu/ctis-public/view/2024-512283-65-00